EU clinical trial 2023-507907-73-00: Unravelling intestinal fibrosis in ulcerative colitis: INTERACT study
Sponsor: Amsterdam UMC (Hospital/Clinic/Other health care facility). Phase: Phase III and phase IV (Integrated). Countries: Netherlands (ended).
Therapeutic area(s): Analytical, Diagnostic and Therapeutic Techniques and Equipment [E] - Diagnosis [E01]; Diseases [C] - Digestive System Diseases [C06]
Gender: Female, Male. Age: 18-64 years, 65+ years. Enrolment: 10.
Status: Ended. Start date (EU): 2024-04-03. End date (EU): 2025-10-23. Decision date: 2023-12-08. Results received: No. Last updated: 2023-12-08.

Condition(s): Ulcerative colitis
Product: GalliUC 370 MBq/mL precursor radiofarmacêutico, solução

Primary endpoint: Identified pathways obtained via pathway analysis (single-cell RNA sequencing). Changes in these identified pathways (in gene and protein expression at week 24 compared to week 0)
Endpoint(s): Binding of [68Ga]Ga-FAPi-46 will be measured using the standardized uptake value (SUV) and target to background ratios will aid in scoring and quantifying tracer uptake. Semi-quantitative uptake above local background will be corrected and uncorrected for tracer plasma concentration based on pharmacokinetic analysis. SUV quantified from the FAPi-PET/CT-scan participants will be compared to non-affected intestinal regions. FAPi PET uptake expressed as SUV. Percentage of SUV decrease at week 24., Changes in gene and protein expression levels expressed as percentages in mucosal biopsies at week 0 and at week 24 (increased/ decreased an to what degree this corresponds to the SUV., Changes in FAPi PET uptake and correlation to clinical (SCCAI score) and endoscopic (Mayo score) changes.

Source: https://euclinicaltrials.eu/ctis-public/view/2023-507907-73-00